EU clinical trial 2023-507785-12-00: Lu AF28996 in Patients With Parkinson's Disease
Protocol code: 18252A
Sponsor: H. Lundbeck A/S (Pharmaceutical company). Phase: Human Pharmacology (Phase I)- Other. Countries: Germany (ended), France (ended), Spain (ended).
Therapeutic area(s): Diseases [C] - Nervous System Diseases [C10]
Gender: Female, Male. Age: 18-64 years, 65+ years. Enrolment: 54.
Status: Ended. Start date (EU): 2024-07-22. End date (EU): 2026-01-05. End date: 2026-02-12. Decision date: 2024-05-24. Results received: No. Last updated: 2025-10-21.
Decision dates by country: FR: 2024-06-03, ES: 2024-05-28, DE: 2024-05-24

Condition(s): Parkinson's Disease

Source: https://euclinicaltrials.eu/ctis-public/view/2023-507785-12-00